EU clinical trial 2024-514845-12-00: A Phase II, Randomized, Double-Blind, PlaceboControlled Study of Ensifentrine in Subjects with Non-Cystic Fibrosis Bronchiectasis
Protocol code: RPL554-NCFB-220
Sponsor: Verona Pharma Inc. (Pharmaceutical company). Phase: Therapeutic exploratory (Phase II). Countries: Spain (ongoing, recruiting), Italy (ongoing, recruiting).
Therapeutic area(s): Diseases [C] - Respiratory Tract Diseases [C08]
Gender: Female, Male. Age: 18-64 years, 65+ years. Enrolment: 70.
Status: Ongoing, recruiting. Start date (EU): 2025-03-28. Decision date: 2025-02-24. Results received: No. Last updated: 2026-07-27.
Decision dates by country: IT: 2025-02-24, ES: 2025-02-27

Condition(s): Non-Cystic Fibrosis Bronchiectasis
Product: Ensifentrine inhalation suspension, The placebo is the same as the ensifentrine suspension except that the active ensifentrine ingredient is omitted (i.e., it consists of phosphate buffered saline and surfactants only); it is also supplied as a single unit-dose LDPE translucent ampule overwrapped in a foil pouch

Primary endpoint: Rate of protocol-defined pulmonary exacerbations over the Treatment period (number of events per subject-year).
Endpoint(s): Time to the onset of the first protocol-defined pulmonary exacerbation over the Treatment period. Change from Baseline at Week 24 in: - E-RS Cough and Sputum Domain score, SGRQ total score, Pre-dose FEV1 (mL) Pre-dose FVC (mL), QOL-B Respiratory Symptoms Domain score, - CAAT total score, Change from Baseline at Weeks 6 and 12 in: - E-RS Cough and Sputum Domain score, SGRQ total score, FEV1 (mL) at Week 12 only, - FVC (mL) at Week 12 only , QOL-B Respiratory Symptoms Domain score, CAAT.

Source: https://euclinicaltrials.eu/ctis-public/view/2024-514845-12-00